EU clinical trial 2024-516914-39-00: A Multicenter, Randomized, Double-Blind Phase 3 Study of HBI-8000 Combined with Nivolumab versus Placebo with Nivolumab in Patients with Unresectable or Metastatic Melanoma Not Previously Treated with PD-1 or PD-L1 Inhibitors
Protocol code: HBI-8000-303
Sponsor: Huyabio International LLC (Pharmaceutical company). Phase: Therapeutic confirmatory (Phase III). Countries: Spain (ongoing, recruitment ended), Italy (ongoing, recruitment ended), France (ongoing, recruitment ended), Belgium (ongoing, recruitment ended), Czechia (ongoing, recruitment ended), Germany (ongoing, recruitment ended).
Therapeutic area(s): Diseases [C] - Neoplasms [C04]
Gender: Female, Male. Age: 0-17 years, 18-64 years, 65+ years. Enrolment: 185.
Status: Ongoing, recruitment ended. Start date (EU): 2022-04-27. Decision date: 2024-10-22. Results received: No. Last updated: 2025-04-02.
Decision dates by country: BE: 2024-10-22, CZ: 2024-10-23, FR: 2024-10-25, IT: 2024-10-28, ES: 2024-11-12, DE: 2024-10-24

Condition(s): Metastatic or unresectable melanoma
Product: OPDIVO 10 mg/mL concentrate for solution for infusion., Tucidinostat

Primary endpoint: The primary endpoint of this study is Progression Free Survival PFS. (PFS) is defined as the time (in days) from the date of randomization to the first date of documented progression as determined by the BIRC, or the date of death due to any cause, whichever occurs first.
Endpoint(s): Objective Response Rate (ORR) The ORR is defined as the percentage of patients enrolled in each arm with a best response of confirmed CR or PR as determined by the BIRC, Overall Survival (OS) The OS is defined as the time from randomization date to the date of death due to any cause.

Source: https://euclinicaltrials.eu/ctis-public/view/2024-516914-39-00